EU clinical trial 2024-513930-39-00: A Multi-arm, Phase 3, Randomized, Placebo Controlled, Double Blind Clinical Trial to Investigate the Efficacy and Safety of Fostemsavir (BMS-663068/GSK3684934) in Heavily Treatment Experienced Subjects Infected with Multi-drug Resistant HIV-1 (BRIGHTE Study)
Protocol code: 205888
Sponsor: Viiv Healthcare UK Limited (Pharmaceutical company). Phase: Therapeutic confirmatory (Phase III). Countries: Romania (ongoing, recruitment ended).
Therapeutic area(s): Diseases [C] - Virus Diseases [C02]
Gender: Female, Male. Age: 18-64 years, 65+ years. Enrolment: 5.
Status: Ongoing, recruitment ended. Start date (EU): 2024-08-30. Decision date: 2024-08-30. Results received: No. Last updated: 2026-04-02.

Condition(s): Heavily Treatment Experienced Subjects Infected with Multi-drug Resistant (MDR) HIV-1
Product: Rukobia 600 mg prolonged-release tablets

Primary endpoint: The efficacy of fostemsavir, relative to placebo, is assessed using the mean change in log10 HIV-1 RNA from Day 1 at Day 8 as determined by ANCOVA in the randomized cohort.
Endpoint(s): •Proportions of subjects in the randomized cohort with HIV-1 RNA decreases •Durability of response at Weeks 24, 48, and 96 of OBT. •Frequency of SAEs, AEs leading to discontinuation, and Grade 3-4 laboratory abnormalities during OBT. •Disease progression during OBT. •Drug resistance testing •Changes in CD4+ T-cells counts and percentages, for Fostemsavir and placebo. •Changes from baseline in HIV-1 RNA, CD4+ cell counts, and percentage of CD4+ T-cells, for Fostemsavir when given with OBT.

Source: https://euclinicaltrials.eu/ctis-public/view/2024-513930-39-00